EU clinical trial 2023-508604-37-00: A Phase 2, Two-Part, Randomized, Double-Blind, Placebo-Controlled, Multicenter Study to Evaluate the Efficacy, Safety, and Tolerability of Subcutaneously Administered REGN7999 (An Inhibitor of TMPRSS6) in Participants with Iron Overload Due to Non-Transfusion Dependent β-Thalassemia.
Protocol code: R7999-BTHAL-2350
Sponsor: Regeneron Pharmaceuticals Inc. (Pharmaceutical company). Phase: Therapeutic exploratory (Phase II). Countries: Greece (ended), Italy (ended).
Therapeutic area(s): Diseases [C] - Musculoskeletal Diseases [C05]
Gender: Female, Male. Age: 18-64 years. Enrolment: 10.
Status: Ended. End date (EU): 2026-06-19. Decision date: 2025-04-15. Results received: No. Last updated: 2026-02-03.
Decision dates by country: GR: 2025-04-15, IT: 2025-04-16

Condition(s): Non-transfusion dependent beta-thalassemia (NTDT), Beta-thalassemia Resultant Iron overload (IOL)
Product: R7999 matching placebo, REGN7999

Primary endpoint: Change from baseline in Liver iron concentration (LIC) by R2* magnetic resonance imaging (MRI)., Incidence of Treatment-emergent adverse events (TEAEs)., Severity of Treatment-emergent adverse events (TEAEs).
Endpoint(s): Achievement of ≥20% reduction in LIC by R2* MRI., Change from baseline in hemoglobin., Change from baseline in LIC by R2* MRI., Percent change from baseline in LIC by R2* MRI., Achievement of ≥20% reduction from baseline LIC by R2*., Change in hemoglobin over time., Achievement of ≥1.5 g/dL increase in hemoglobin for two consecutive assessments in the absence of red blood cell (RBC) transfusions., Number of RBC transfusions required., Achievement of transfusion independence., Change in RBC counts over time., Concentrations of REGN7999 in serum over time., Incidence of anti-drug antibody (ADA) to REGN7999 over time., Magnitude of ADA to REGN7999 over time.

Source: https://euclinicaltrials.eu/ctis-public/view/2023-508604-37-00